EU clinical trial 2024-512498-29-00: Extracellular Vesicle-enriched Secretome Fraction (VSF1.01) for the Reduction of Cochlear Implant Surgery Related Trauma (ESCRT). An open-label monocentric phase I/IIa pilot study to investigate the safety of intracochlear application of VSF1.01 enriched with hUC-MSC-EVs in patients receiving cochlear implantation.
Protocol code: ESCRT
Sponsor: Medizinische Hochschule Hannover (Educational Institution). Phase: Phase I and Phase II (Integrated)- First administration to humans. Countries: Germany (ongoing, recruitment ended).
Therapeutic area(s): Diseases [C] - Otorhinolaryngologic Diseases [C09]
Gender: Female, Male. Age: 18-64 years, 65+ years. Enrolment: 11.
Status: Ongoing, recruitment ended. Start date (EU): 2025-09-24. Decision date: 2024-10-10. Results received: No. Last updated: 2025-02-28.

Condition(s): hearing loss

Primary endpoint: In order to assess safety of patients, a clinical evaluation of each patient is performed. Number and severity of adverse events (AEs/SAEs) will be recorded and documented and represent the primary endpoints of the ESCRT study to create a safety profile
Endpoint(s): Ad 1) the measurement of electrically evoked compound action potential (eCAP; eCAP growth function) in order to evaluate health of the auditory nerve, Ad 2) Speech perception in quiet and in noise will be evaluated by use of the Freiburg monosyllable test (FBM), the Hochmair-Schulz-Moser sentence test (HSM; at a signal to noise ratio (SNR) of 10 dB and a SNR of 5 dB) and the Oldenburger sentence test (OLSA, measuring the SNR that allows 50% speech intelligibility)., Ad 3) Air and bone conduction from 125 Hz – 16,000 Hz will be measured by pure tone audiometry to assess the hearing thresholds., Ad 4) Impedance levels of the electrode contacts are determined and are a measure to rule out pathological levels of impedances (which can be an indication for ossification, intensive fibrosis formation, or failure of electrodes). This is part of the clinical routine investigation after cochlear implantation.

Source: https://euclinicaltrials.eu/ctis-public/view/2024-512498-29-00